EU clinical trial 2024-511568-96-00: Safety and pharmacokinetics of antipsychotics in children 2: Studying TDM in an RCT
Protocol code: NL75882.078.20
Sponsor: Erasmus Universitair Medisch Centrum Rotterdam (Erasmus MC) (Hospital/Clinic/Other health care facility). Phase: Therapeutic use (Phase IV). Countries: Netherlands (ongoing, recruiting), Germany (ended).
Therapeutic area(s): Analytical, Diagnostic and Therapeutic Techniques and Equipment [E] - Therapeutics [E02]; Psychiatry and Psychology [F] - Mental Disorders [F03]
Gender: Female, Male. Age: 0-17 years, 18-64 years. Enrolment: 280.
Start date (EU): 2024-07-16. Decision date: 2024-07-16. Results received: No. Last updated: 2024-07-31.
Decision dates by country: DE: 2024-07-31, NL: 2024-07-16

Condition(s): Autism spectrum disorder
Product: ARIPIPRAZOLE, RISPERIDONE

Primary endpoint: Difference between the groups in change in body mass index z-scores (BMI-Z) after 6 months of treatment
Endpoint(s): Difference between the groups in change in body mass index z-scores (BMI-Z) after 12 months of treatment., Aberrant Behavior Checklist, a parental symptom checklist for assessing problem behaviour in children. The gold standard for measuring the effect of treatment on aggression and irritability in children with autism spectrum disorder, EuroQol-5D Youth. A descriptive system for health-related quality of life states in five dimensions, plus a visual analogue scale., Pediatric Quality of Life Inventory. A modular instrument aimed at measuring healthrelated quality of life in children and adolescents. It showed excellent reliability and validity in individuals with autism spectrum disorder, Clinical Global Improvement, Treatment Inventory of Costs in Patients with psychiatric disorders. A modular questionnaire aimed at mapping healthcare utilization and the repercussions of psychosocial problems, allowing for the assessment of associated costs., Levels of glucose, cholesterol, lipoproteins and triglycerides; the hormones ghrelin, prolactin and leptin., Abnormal Involuntary Movement Scale, a clinician administered observational scale aimed at detecting extrapyramidal side effects., Blood pressure

Source: https://euclinicaltrials.eu/ctis-public/view/2024-511568-96-00